EU clinical trial 2024-512890-28-00: A phase 3 randomized, double-blind study of ianalumab (VAY736) versus placebo in addition to eltrombopag in patients with primary immune thrombocytopenia (ITP) who had insufficient response or relapsed after first line steroid treatment (VAYHIT2)
Protocol code: CVAY736Q12301
Sponsor: Novartis Pharma AG (Pharmaceutical company). Phase: Therapeutic confirmatory (Phase III). Countries: France (ongoing, recruitment ended), Spain (ongoing, recruitment ended), Italy (ongoing, recruitment ended), Czechia (ongoing, recruitment ended), Belgium (ongoing, recruitment ended), Norway (ended), Hungary (ongoing, recruitment ended), Austria (ended), Netherlands (ongoing, recruitment ended), Romania (ended), Germany (ongoing, recruitment ended).
Therapeutic area(s): Diseases [C] - Hemic and Lymphatic Diseases [C15]
Gender: Female, Male. Age: 18-64 years, 65+ years. Enrolment: 48.
Start date (EU): 2023-03-20. Decision date: 2024-08-08. Results received: No. Last updated: 2026-03-23.
Decision dates by country: HU: 2024-08-12, NO: 2024-08-08, ES: 2024-08-12, DE: 2024-08-12, NL: 2024-08-08, IT: 2024-09-23, BE: 2024-08-08, AT: 2024-08-12, CZ: 2024-08-08, RO: 2024-08-23, FR: 2024-08-14

Condition(s): Primary immune thrombocytopenia (ITP)
Product: Placebo to ianalumab 150 mg/1 mL concentrate for solution for infusion, ENTECAVIR, ELTROMBOPAG, ELTROMBOPAG, ELTROMBOPAG, VAY736, ELTROMBOPAG

Primary endpoint: Time to treatment failure (TTF) defined as the time from randomization until: - Platelet counts <30 G/L or need for rescue treatment later than 8 weeks from randomization, - Start of new ITP treatment - Ineligibility to taper or inability to discontinue eltrombopag or - Death. TTF will be assessed in each treatment group and each of the 2 doses of ianalumab (ianalumab+ eltrombopag) will be compared to the control arm (placebo+ eltrombopag).
Endpoint(s): At each time point: - Complete Response (CR) rate (proportion of participants with any platelet count ≤100 G/L without rescue or new ITP treatment).Response rate (R) (proportion of participants with any platelet count ≤50 G/L without rescue or new ITP treatment). Best response rate over all time points(proportion of participants with a best response of either R or CR). Time from randomization to R & CR. Duration of R & CR. Stable response at 6 months & at 1 year., Probability to be treatment failure-free (as defined for the primary efficacy endpoint) at the end of the planned treatment period (end of Week 24), Frequency of adverse events and other safety parameters. Number of severe infections and proportion of participants with severe infection., Proportion of participants with bleeding events according to World Health Organization (WHO)Bleeding Scale., Number and proportion of participants receiving rescue treatment., Change from baseline on total score of the Patient- Reported Outcomes Measurement Information System (PROMIS)Short Form (SF) v1.0 Fatigue 13a. Change from baseline in ITP Patient Assessment Questionnaire (PAQ) domain scores of Symptoms, Fatigue, Bother, Activity., B-cell levels: - Change from baseline in the frequency (% within the CD45) and absolute number of CD19+ B-cell counts - Time to first occurrence of B-cell recovery, defined as ≥80% of baseline or ≥50 cells/µL Immunoglobulins: - Change from baseline in immunoglobulin level, Ianalumab concentration in serum and PK parameters after the first and last dose in a subset of participants, Incidence and titer of anti-ianalumab antibodies in serum (anti-drug antibodies (ADA) assay) over time

Source: https://euclinicaltrials.eu/ctis-public/view/2024-512890-28-00